EU clinical trial 2023-506545-27-01: A randomised, double-blind, placebo controlled, parallel group, multi-centre trial in adult subjects with newly diagnosed type 1 diabetes mellitus investigating the effect of Verapamil SR on preservation of beta-cell function (VER-A-T1D)
Protocol code: Ver-A-T1D
Sponsor: Medical University Of Graz (Educational Institution). Phase: Therapeutic exploratory (Phase II). Countries: France (ended), Germany (ended), Belgium (ended), Italy (ended), Austria (ended).
Therapeutic area(s): Phenomena and Processes [G] - Metabolism [G03]
Gender: Female, Male. Age: 18-64 years. Enrolment: 64.
Status: Ended. Start date (EU): 2025-01-28. End date (EU): 2026-04-17. Decision date: 2025-01-21. Results received: No. Last updated: 2026-05-20.
Decision dates by country: AT: 2025-01-27, FR: 2025-01-21, BE: 2025-01-22, IT: 2025-01-28, DE: 2025-01-22

Condition(s): Diabetes mellitus, Type 1
Product: VeraHEXAL KHK 120 mg retard Retardtabletten, Placebo to VeraHEXAL KHK 120 mg retard Retardtabletten

Primary endpoint: The area under the stimulated C-peptide response curve over the first two hours of a mixed meal tolerance test (MMTT) after 12 months therapy compared to placebo
Endpoint(s): The area under the stimulated C-peptide response curve over the first two hours of a mixed meal tolerance test (MMTT) at 3, 6, 9 months, Proinsulin , Insulin, Pro-IAPP and Proglucagon secretion during the first two hours of a mixed meal tolerance test (MMTT) at baseline and 3, 6, 9 an 12 months, Fasting C-peptide after 12 months therapy compared to placebo, The DBS C-peptide measurements at all observation times, Change in HbA1c baseline to 12 months, Number of treatment emergent severe hypoglycaemic episodes. Severe hypoglycaemia denotes severe cognitive impairment requiring external assistance for recovery according to the American Diabetes Association (ADA), Number of treatment emergent episodes of diabetic ketoacidosis (DKA), Change in insulin requirements, baseline to 12 months as the daily total dose (three days average) in units per kg BW, Change in T1D associated autoantibodies (GADA, IAA, IA-2A and ZnT8A) from baseline to 12 months, CGM time in range (70-180 mg/dL, 3.9-10.0 mmol/L) and (70-140 mg/dL, 3.9-7.8 mmol/L), time above range (>180 mg/dL, >10.0 mmol/L), time below range (<70 mg/dL, < 3.9 mmol/L), The area under the stimulated C-peptide response curve over the first two hours of a mixed meal tolerance test (MMTT) at 24 months, Change in HbA1c baseline to 24 months, Change in insulin requirements, baseline to 24 months as the daily total dose (three days average) in units per kg BW

Source: https://euclinicaltrials.eu/ctis-public/view/2023-506545-27-01